EU clinical trial 2024-519615-34-00: A study in healthy people to test how 3 different formulations of BI 764198 are taken up in the body and how this is influenced by food
Protocol code: 1434-0006
Sponsor: Boehringer Ingelheim International GmbH (Pharmaceutical company). Phase: Human Pharmacology (Phase I)- Other. Countries: Germany (ended).
Therapeutic area(s): Not possible to specify
Gender: Female, Male. Age: 18-64 years. Enrolment: 17.
Status: Ended. Start date (EU): 2025-05-19. End date (EU): 2025-07-14. Decision date: 2025-03-21. Results received: No. Last updated: 2025-05-27.

Condition(s): healthy volunteer trial

Source: https://euclinicaltrials.eu/ctis-public/view/2024-519615-34-00